EU clinical trial 2023-503629-20-00: A Phase Ib/II, Open-Label, Multicenter, Randomized Umbrella Study Evaluating the Efficacy and Safety of Multiple Treatment Combinations in Patients with Metastatic Breast Cancer (MORPHEUS-panBC)
Protocol code: CO40115
Sponsor: F. Hoffmann-La Roche AG (Pharmaceutical company). Phase: Phase I and Phase II (Integrated)- Other. Countries: Germany (ongoing, recruiting), Spain (ongoing, recruiting), France (ongoing, recruiting).
Therapeutic area(s): Diseases [C] - Neoplasms [C04]
Gender: Female, Male. Age: 18-64 years, 65+ years. Enrolment: 56.
Status: Ongoing, recruiting. Start date (EU): 2018-06-27. Decision date: 2024-06-13. Results received: No. Last updated: 2026-04-06.
Decision dates by country: FR: 2024-07-01, DE: 2024-06-13, ES: 2024-06-13

Condition(s): Metastatic breast cancer, including triple negative breast cancer (TNBC), hormone receptor positive breast cancer (HR+ BC), and HER2 positive and HER2 low breast cancer (HER2+/HER2-low BC)
Product: RO7881583, EMPAGLIFLOZIN, Fulvestrant EVER Pharma 250 mg Injektionslösung in einer Fertigspritze, SACITUZUMAB GOVITECAN, Verzenios 100 mg film-coated tablets, EMPAGLIFLOZIN, PALBOCICLIB, INAVOLISIB, Tecentriq 1 200 mg concentrate for solution for infusion, LETROZOLE ACCORD HEALTHCARE 2,5 mg, comprimé pelliculé, PALBOCICLIB, PALBOCICLIB, RoActemra 20 mg/mL concentrate for solution for infusion, Kisqali 200 mg film-coated tablets, Verzenios 50 mg film-coated tablets, Tecentriq, Abraxane 5 mg/ml powder for dispersion for infusion., PALBOCICLIB, Faslodex 250 mg solution for injection., Letrozol STADA® 2,5 mg Filmtabletten, FULVESTRANT ACCORD 250 mg, solution injectable en seringue pré-remplie, Kisqali 200 mg film-coated tablets, Verzenios 150 mg film-coated tablets, ACTEMRA, PALBOCICLIB, INAVOLISIB, Kisqali 200 mg film-coated tablets, PALBOCICLIB, INAVOLISIB, METFORMIN

Primary endpoint: Stage 1 1. ORR, Stage 1 and 2 1. Incidence, nature, and severity of adverse events and laboratory abnormalities, with severity determined according to NCI CTCAE v4.0, Stage 1 and 2 2. Change from baseline in vital signs and ECG parameters, Stage 1 and 2 3. Change from baseline in targeted clinical laboratory test results
Endpoint(s): Stage 1 1. PFS, Stage 1 2. DCR, Stage 1 3. OS, Stage 1 4. DOR, Stage 1 5. OS at specific timepoints

Source: https://euclinicaltrials.eu/ctis-public/view/2023-503629-20-00